EU clinical trial 2023-503243-34-00: A Phase I Study of INCB099280 in Combination With Ipilimumab in Participants With Selected Solid Tumors
Protocol code: INCB 99280-205
Sponsor: Incyte Corp. (Pharmaceutical company). Phase: Human Pharmacology (Phase I)- Other. Countries: Sweden (ended), Norway (ended), Slovakia (ended).
Therapeutic area(s): Diseases [C] - Neoplasms [C04]
Gender: Female, Male. Age: 18-64 years, 65+ years. Enrolment: 23.
Status: Ended. End date (EU): 2024-04-09. End date: 2024-11-08. Decision date: 2024-02-19. Results received: Yes. Last updated: 2024-04-22.
Decision dates by country: SK: 2024-02-19, NO: 2024-02-20, SE: 2024-02-23

Condition(s): Solid tumor
Product: INCB099280, YERVOY 5 mg/ml concentrate for solution for infusion, YERVOY 5 mg/ml concentrate for solution for infusion

Primary endpoint: Occurrence of DLTs, Incidence of TEAEs, assessed by physical examinations, changes in vital signs and ECGs, and analysis of clinical laboratory samples, Incidence of TEAEs leading to dose interruption, dose reduction, or discontinuation of either of the study drugs
Endpoint(s): Concentration of INCB099280 in plasma, Objective response, defined as having a best overall response of CR or PR by investigator assessment per RECIST v1.1., Disease control, defined as having a best overall response of CR or PR, or SD of ≥ 15 weeks after initiation of study treatment, by investigator assessment per RECIST v1.1., DOR, defined as the time from the earliest date of CR or PR until the earliest date of disease progression (by investigator assessment per RECIST v1.1) or death due to any cause if occurring sooner than progression.

Source: https://euclinicaltrials.eu/ctis-public/view/2023-503243-34-00